EU clinical trial 2023-508127-13-00: A Phase II, single arm, multicenter open label trial to determine the efficacy and safety of tisagenlecleucel (CTL019) in adult patients with refractory or relapsed follicular lymphoma
Protocol code: CCTL019E2202
Sponsor: Novartis Pharma AG (Pharmaceutical company). Phase: Therapeutic exploratory (Phase II). Countries: Italy (ended), Belgium (ended), Germany (ended), Spain (ended), Netherlands (ended), Norway (ended), France (ended).
Therapeutic area(s): Diseases [C] - Neoplasms [C04]
Gender: Female, Male. Age: 18-64 years, 65+ years. Enrolment: 41.
Status: Ended. Start date (EU): 2019-01-25. End date (EU): 2025-03-27. End date: 2025-05-28. Decision date: 2024-02-05. Results received: Yes. Last updated: 2024-12-13.
Decision dates by country: BE: 2024-02-12, FR: 2024-02-06, DE: 2024-02-08, IT: 2024-02-08, ES: 2024-02-12, NO: 2024-02-05, NL: 2024-02-05

Condition(s): Adult patients with refractory or relapsed follicular lymphoma
Product: TISAGENLECLEUCEL

Primary endpoint: 1. Complete response rate (CRR) determined by an Independent Review Committee (IRC) in the efficacy analysis set (EAS) based on Lugano 2014 classification response criteria (Cheson et al 2014).
Endpoint(s): ORR, including complete response (CR) and partial response (PR) determined by IRC in the FAS based on Lugano 2014 classification. DOR, defined as time from CR/PR to relapse or death due to FL, based on IRC DOR for CR only, defined as time from CR to relapse or death due to FL, based on IRC. PFS, defined as time from tisagenlecleucel infusion to first documented disease progression or death due to any cause, based on IRC.OS, defined as time from tisagenlecleucel infusion to death due to any cause, Type, frequency and severity of adverse events and laboratory abnormalities, Summary of: -qPCR detected tisagenlecleucel transgene concentrations in peripheral blood, bone marrow and other tissues by time point and clinical response status. -cellular kinetic parameters: Cmax, Tmax, AUC0-28 and AUC0-84d, T1/2, and/or other relevant parameters in peripheral blood; bone marrow and other tissues by clinical response as appropriate -exposure and cellular kinetic parameters of CD3+ tisagenlecleucel cells in peripheral blood detected by flow cytometry, Summary of pre-existing and treatment induced immunogenicity (cellular and humoral) of tisagenlecleucel, Levels of pre-existing and treatment induced immunogenicity Cellular kinetic parameters (Cmax, AUCs, Tlast), concentration-time profile tisagenlecleucel by immunogenicity category (positive/negative) Efficacy (ORR, DOR, PFS) Safety (B-cell levels, CRS grades, neurologic events), Summary scores of PRO measured by SF-36 version 2, EQ-5D-3L and FACT-Lym quality of life questionnaires

Source: https://euclinicaltrials.eu/ctis-public/view/2023-508127-13-00